EU clinical trial 2025-523695-23-00: Pharmacokinetics of NTRX-07 in fed and fasted participants
Protocol code: NTRX-07-C110
Sponsor: Neurotherapia Inc. (Pharmaceutical company). Phase: Human Pharmacology (Phase I)- Other. Countries: Hungary (ongoing, recruiting).
Therapeutic area(s): Diseases [C] - Nervous System Diseases [C10]
Gender: Female, Male. Age: 18-64 years. Enrolment: 24.
Status: Ongoing, recruiting. Start date (EU): 2025-12-11. Decision date: 2025-11-19. Results received: No. Last updated: 2025-11-19.

Condition(s): Not applicable (trial is a pharmacokinetic study in healthy volunteers). Intended indication: neuroinflammation-related diseases, including Alzheimer’s Disease

Source: https://euclinicaltrials.eu/ctis-public/view/2025-523695-23-00